EU clinical trial 2023-503548-14-00: Clinical trial to compare availability in the body of the active substance nicotine as well as patch adhesion of the newly developed patch LTS Nicotine TTS vs. Nicotinell® (21 mg/24 h) in healthy smokers after single patch application
Protocol code: LTS 01/23
Sponsor: LTS LOHMANN Therapie-Systeme AG (Pharmaceutical company). Phase: Human Pharmacology (Phase I)- Bioequivalence Study. Countries: Germany (ended).
Therapeutic area(s): Psychiatry and Psychology [F] - Behavior and Behavior Mechanisms [F01]
Gender: Female, Male. Age: 18-64 years. Enrolment: 30.
Status: Ended. Start date (EU): 2024-09-30. End date (EU): 2024-11-15. Decision date: 2023-05-22. Results received: No. Last updated: 2024-09-26.

Condition(s): bioequivalence and patch adhesion trial; therapeutical indication not studied

Source: https://euclinicaltrials.eu/ctis-public/view/2023-503548-14-00